EU clinical trial 2023-509340-10-00: A randomized, open-label, phase 3 trial comparing the efficacy and safety of OSE2101 versus docetaxel in HLA-A2 positive patients with metastatic Non-Small Cell Lung Cancer (NSCLC) and secondary resistance to Immune Checkpoint Inhibitor (ICI) - ARTEMIA study
Protocol code: OSE2101C302
Sponsor: OSE Immunotherapeutics (Pharmaceutical company). Phase: Therapeutic confirmatory (Phase III). Countries: France (ongoing, recruiting), Portugal (ongoing, recruiting), Netherlands (ongoing, recruiting), Poland (ongoing, recruiting), Romania (ongoing, recruiting), Hungary (ongoing, recruiting), Germany (ongoing, recruiting), Belgium (ongoing, recruiting), Spain (ongoing, recruiting), Italy (ongoing, recruiting), Greece (ongoing, recruiting).
Therapeutic area(s): Diseases [C] - Neoplasms [C04]
Gender: Female, Male. Age: 18-64 years, 65+ years. Enrolment: 340.
Status: Ongoing, recruiting. Start date (EU): 2024-10-29. Decision date: 2024-09-03. Results received: No. Last updated: 2026-04-27.
Decision dates by country: PT: 2024-09-04, DE: 2024-09-09, PL: 2024-09-06, RO: 2024-09-09, HU: 2024-09-09, NL: 2024-09-04, ES: 2024-09-05, IT: 2024-09-06, GR: 2024-09-09, FR: 2024-09-03, BE: 2024-09-03

Condition(s): Patients with HLA-A2 positive phenotype and metastatic Non-Small Cell Lung Cancer.
Product: DOCETAXEL, TEDOPI

Primary endpoint: OS defined as time from randomization to death of any cause

Source: https://euclinicaltrials.eu/ctis-public/view/2023-509340-10-00